EU clinical trial 2024-517927-37-00: A Pilot, Randomized, Double-Blinded, Controlled Study of Hemodynamic and Acid Base Effects of 0.5M Sodium Lactate and 3% Saline Solutions in Septic Shock Patients
Protocol code: MJIP1.0
Sponsor: Fakultni Nemocnice Plzen (Hospital/Clinic/Other health care facility). Phase: Therapeutic exploratory (Phase II). Countries: Czechia (ongoing, recruiting).
Therapeutic area(s): Analytical, Diagnostic and Therapeutic Techniques and Equipment [E] - Therapeutics [E02]
Gender: Female, Male. Age: 18-64 years, 65+ years. Enrolment: 40.
Status: Ongoing, recruiting. Start date (EU): 2024-11-24. Decision date: 2024-11-11. Results received: No. Last updated: 2025-03-19.

Condition(s): Patients suffering from septic shock who require fluid resuscitation.
Product: SODIUM LACTATE

Primary endpoint: Change in cardiac stroke work (SW = SV x MAP) assessed by means of transthoracic echocardiography (SV) and a fluid filled arterial pressure transducer system (MAP) measured at time of start of infusion, at 30 minutes and at 60 minutes from the start of the respective fluid bolus (0.5M HSL or 3% NaCl). Monitored parameters: • SV (mL; start of infusion, 30 min and 60 min after start of infusion) • MAP (mmHg; start of infusion, 30 min and 60 min after start of infusion)
Endpoint(s): Comparison of laboratory values of arterial blood gases and electrolytes between study groups

Source: https://euclinicaltrials.eu/ctis-public/view/2024-517927-37-00